EU clinical trial 2023-509217-37-00: Influence of various fast-acting mealtime insulin preparations in individuals with type 1 diabetes, with slow, moderate, and rapid gastric emptying, on postprandial blood glucose and the formation of reactive oxygen species
Protocol code: KKB_2023_FActIn-T1DM
Sponsor: Katholisches Klinikum Bochum gGmbH (Hospital/Clinic/Other health care facility). Phase: Human Pharmacology (Phase I)- Other. Countries: Germany (ended).
Therapeutic area(s): Diseases [C] - Nutritional and Metabolic Diseases [C18]
Gender: Female, Male. Age: 18-64 years, 65+ years. Enrolment: 20.
Status: Ended. Start date (EU): 2024-06-25. End date (EU): 2026-05-07. Decision date: 2024-03-27. Results received: No. Last updated: 2025-09-17.

Condition(s): Type 1 Diabetes
Product: Lyumjev 100 units/mL solution for injection in vial, Huminsulin® Normal 100 100 I.E./ml Injektionslösung in Durchstechflasche, Humalog 100 units/ml solution for injection in vial

Primary endpoint: The primary endpoint is defined as the proportion of participants who achieve the lowest AUC glucose with ultra-rapid-acting insulin analog in the tertiles with the fastest vs. the slowest gastric emptying (t1/2), compared to the proportion of participants who achieve the lowest AUCglucose with regular insulin in the tertiles with the slowest vs. the fastest gastric emptying (t1/2)
Endpoint(s): Comparison of meal-associated excursions of ROS (Nitrotyrosine, oxidized Low-Density Lipoproteins (oxLDL)), Comparison of meal-associated excursions of plasma glucose and triglyceride concentrations, Comparison of gastric emptying rates (t1/2), Coefficient of variation of gastric emptying variability (t1/2), Correlation of AUCglucose with gastric emptying (t1/2) considering the choice of insulin preparation (ultra-rapid-acting insulin, rapid-acting insulin, and regular insulin)

Source: https://euclinicaltrials.eu/ctis-public/view/2023-509217-37-00